EU clinical trial 2024-512653-25-00: Therapeutic effect of Hydroxychloroquine on IgA Nephropathy course QUIgAN Study
Protocol code: 20PH284
Sponsor: Centre Hospitalier Universitaire De Saint Etienne (Hospital/Clinic/Other health care facility). Phase: Therapeutic confirmatory (Phase III). Countries: France (ongoing, recruiting).
Therapeutic area(s): Not possible to specify
Gender: Female, Male. Age: 18-64 years, 65+ years. Enrolment: 334.
Status: Ongoing, recruiting. Start date (EU): 2025-06-26. Decision date: 2024-09-09. Results received: No. Last updated: 2026-06-12.

Condition(s): IgA nephropathy
Product: placebo plaquenil pharmaceutical form: tablets active substance: not applicable, PLAQUENIL 200 mg comprimés pelliculés sulfate d’hydroxychloroquine

Primary endpoint: GFR slope form inclusion to 3 years
Endpoint(s): Difference between groups regarding routine nephrological clinical follow-up (proteinuria, albuminuria, GFR, hematuria, systolic and diastolic blood pressure) at 1, 2 and 3 years, Difference in proportion of end stage renal disease (GFR< 15mL/min/1.73m²) and deaths, Proportion of adverse events (pruritus, gastro-intestinal disorders) and serious adverse events (QT enlargement, cardiomyopathy, ophthalmologic disorders, neuromyopathy, cytopenia), Correlations between hydroxychloroquine trough levels (mean trough level and maximum trough level) and evolution of proteinuria, eGFR, blood pressure, Correlations between hydroxychloroquine trough levels (mean trough level and maximum trough level) and adverse events (QT interval measurement, any adverse event, serious adverse events), Biocollection of plasma, serum, urine and DNA samples

Source: https://euclinicaltrials.eu/ctis-public/view/2024-512653-25-00